EU clinical trial 2024-511255-17-00: Pressurized intrathoracic aerosol chemotherapy (PITAC) in patients with malignant pleural effusion: a single-center phase II trial. PITAC_ MaPEPi
Protocol code: PITAC_ MaPEPi
Sponsor: Azienda Ospedaliero Universitaria Pisana (Hospital/Clinic/Other health care facility). Phase: Therapeutic exploratory (Phase II). Countries: Italy (not authorised).
Therapeutic area(s): Diseases [C] - Neoplasms [C04]
Gender: Female, Male. Age: 18-64 years, 65+ years. Enrolment: 40.
Status: Not authorised. Decision date: 2025-12-22. Results received: No. Last updated: 2025-12-22.

Condition(s): Pleural carcinosis
Product: Cisplatino Accord Healthcare Italia 1 mg/ml concentrato per soluzione per infusione, DOXORUBICINA ACCORD HEALTHCARE ITALIA 2 mg/ml concentrato per soluzione per infusione

Primary endpoint: PITAC efficacy will be evaluated in terms of pleurodesis and therefore of the control of the entity of MPE volume at 1, 3 and 6 months after the surgical procedure. Therapeutic efficacy will be assessed according to the criteria of the WHO for the treatment response of MPE after surgery. In this study, the effective objective response in terms of pleurodesis after PITAC will include CR and PR.
Endpoint(s): The safety of PITAC measured in terms of complications and mortality. For this purpose, intra- and post-operative variables will be recorded, in addition to the demographic and clinical characteristics of the study population. Mortality at 30- and 90-days from the surgical procedure will be recorded

Source: https://euclinicaltrials.eu/ctis-public/view/2024-511255-17-00